EU clinical trial 2023-509628-16-00: A Phase 3, Multicenter, Randomized, Open-label Study of Ifinatamab Deruxtecan (I-DXd), a B7-H3 Antibody-Drug Conjugate (ADC), Versus Treatment of Physician’s Choice (TPC) in Subjects with Relapsed Small Cell Lung Cancer (SCLC) (IDeate-Lung02)
Protocol code: DS7300-188
Sponsor: Daiichi Sankyo Inc. (Pharmaceutical company). Phase: Therapeutic confirmatory (Phase III). Countries: Netherlands (ongoing, recruiting), Hungary (ongoing, recruiting), Italy (ongoing, recruiting), Romania (ongoing, recruiting), France (ongoing, recruiting), Spain (ongoing, recruiting), Poland (ongoing, recruiting), Belgium (ongoing, recruiting), Germany (ongoing, recruiting), Austria (authorised, recruitment pending), Czechia (authorised, recruiting), Greece (ongoing, recruiting), Portugal (ongoing, recruiting).
Therapeutic area(s): Diseases [C] - Neoplasms [C04]
Gender: Female, Male. Age: 18-64 years, 65+ years. Enrolment: 272.
Start date (EU): 2026-05-07. Decision date: 2024-08-19. Results received: No. Last updated: 2026-07-01.
Decision dates by country: ES: 2024-08-21, DE: 2024-08-22, HU: 2024-08-26, RO: 2024-08-26, GR: 2025-08-14, NL: 2024-08-20, BE: 2024-08-21, PL: 2024-08-26, AT: 2025-11-03, CZ: 2025-07-30, FR: 2024-08-19, PT: 2025-07-23, IT: 2024-08-20

Condition(s): Small Cell Lung Cancer (SCLC)
Product: TOPOTECAN, Ifinatamab deruxtecan, TOPOTECAN

Primary endpoint: Objective Response Rate (ORR): The percentage of participants who show a confirmed complete response (no detectable cancer) or confirmed partial response (reduced tumor size) as assessed by blinded independent central review., Overall Survival (OS): The time interval from the date of randomization to the date of death due to any cause.
Endpoint(s): ORR as assessed by the investigator, progression-free survival, duration of response, disease control rate, time to response, PROs measures of health-related quality of life, adverse events, antidrug antibody prevalence, correlation of B7-H3 protein expression in tumor tissue with clinical outcomes, and PK.

Source: https://euclinicaltrials.eu/ctis-public/view/2023-509628-16-00